EU clinical trial 2022-500281-10-02: An Open-label, Dose-Finding, Phase 1/2 Study to Evaluate the Safety and Tolerability of a Single Intravenous Dose of LY3884961 in Subjects with Peripheral Manifestations of Gaucher Disease
Protocol code: J3Z-MC-OJAE
Sponsor: Prevail Therapeutics Inc. (Pharmaceutical company). Phase: Phase I and Phase II (Integrated)- Other. Countries: Germany (temporarily halted), Spain (temporarily halted).
Therapeutic area(s): Diseases [C] - Congenital, Hereditary, and Neonatal Diseases and Abnormalities [C16]
Gender: Female, Male. Age: 18-64 years, 65+ years. Enrolment: 6.
Status: Temporarily halted. Start date (EU): 2026-02-06. Decision date: 2023-09-05. Results received: No. Last updated: 2026-03-10.
Decision dates by country: ES: 2023-09-05, DE: 2023-09-06

Condition(s): Type 1 Gaucher Disease (Peripheral/Non-neuronopathic Manifestations)
Product: Rapamune 1 mg coated tablets, SIROLIMUS, LY3884961, PREDNISONA CINFA 10 MG COMPRIMIDOS, ECULIZUMAB, PREDNISONE, Prednisone Mylan Pharma 5 mg compresse, Rapamune 0.5 mg coated tablets, SIROLIMUS, PREDNISONE, Solu-Medrol 1000 mg por és oldószer oldatos injekcióhoz, Rapamune 0.5 mg coated tablets, METHYLPREDNISOLONE, Rapamune 1 mg coated tablets

Primary endpoint: Incidence and severity of TEAEs and SAEs, including clinically significant changes in vital signs, clinical laboratory parameter assessments, 12-lead ECGs, results of abdominal and bone MRIs, physical and neurological examinations, and waist circumference and weight over time.
Endpoint(s): Change and percent change from baseline in spleen volume (MN), Change from baseline in platelet count, Change from baseline in GCase enzyme activity and protein levels and GluSph levels, Time from LY3884961 to ERT/SRT discontinuation., Time from discontinuation of ERT/SRT to re-initiation of ERT/SRT.

Source: https://euclinicaltrials.eu/ctis-public/view/2022-500281-10-02